EU clinical trial 2023-504035-40-00: MITO CERV4: Single arm phase II study on Pembrolizumab in pre neoplastic high grade HPV-related vulvar and cervical lesions
Protocol code: MITO CERV 4
Sponsor: Fondazione Policlinico Universitario Agostino Gemelli IRCCS (Hospital/Clinic/Other health care facility). Phase: Therapeutic exploratory (Phase II). Countries: Italy (authorised, recruitment pending).
Therapeutic area(s): Diseases [C] - Neoplasms [C04]
Gender: Female. Age: 18-64 years, 65+ years. Enrolment: 45.
Status: Authorised, recruitment pending. Decision date: 2024-11-12. Results received: No. Last updated: 2025-09-01.

Condition(s): Patients with pre neoplastic high grade HPV-related vulvar and cervical lesions
Product: KEYTRUDA 25 mg/mL concentrate for solution for infusion

Primary endpoint: Proportion of subjects with no evidence of cervical HSIL on histology at surgical treatment.
Endpoint(s): Proportion of subjects with no evidence of vulvar VIN 2-3 on histology at surgical treatment., Incidence and severity of systemic events for the duration of the study (CTCAE version 5.0)., Proportion of subjects with downstaging of cervical and vulvar pre-neoplastic lesion on histology., Proportion of patients with no evidence of HPV by HPV testing at Week 36 visit., Proportion of subjects with no progression of cervical HSIL and vulvar VIN 2-3 to cervical and vulvar carcinoma respectively from baseline on histology.

Source: https://euclinicaltrials.eu/ctis-public/view/2023-504035-40-00